EU clinical trial 2023-508056-19-00: DESTINY-Endometrial01: An Open-Label, Sponsor-Blinded, Randomized, Controlled, Multicenter, Phase III Study of Trastuzumab Deruxtecan (T-DXd) Plus Rilvegostomig or Pembrolizumab vs Chemotherapy Plus Pembrolizumab as First-Line Therapy of HER2-Expressing (IHC 3+/2+), Mismatch Repair Proficient (pMMR), Primary Advanced or Recurrent Endometrial Cancer
Protocol code: DESTINYEndometrial01
Sponsor: AstraZeneca AB (Pharmaceutical company). Phase: Therapeutic confirmatory (Phase III). Countries: Denmark (authorised, recruiting), Norway (ongoing, recruiting), Spain (ongoing, recruiting), Netherlands (not authorised), Hungary (ongoing, recruiting), Belgium (ongoing, recruiting), Austria (authorised, recruiting), Sweden (ongoing, recruiting), Italy (ongoing, recruiting), France (ongoing, recruiting), Finland (ongoing, recruiting), Germany (ongoing, recruiting), Poland (ongoing, recruiting).
Therapeutic area(s): Diseases [C] - Neoplasms [C04]
Gender: Female. Age: 18-64 years, 65+ years. Enrolment: 219.
Start date (EU): 2025-10-02. Decision date: 2025-07-21. Results received: No. Last updated: 2026-02-10.
Decision dates by country: NO: 2025-07-25, NL: 2025-07-28, PL: 2025-07-28, HU: 2025-07-22, IT: 2025-07-24, ES: 2025-07-24, AT: 2025-07-24, FR: 2025-07-25, SE: 2025-07-22, FI: 2025-07-22, BE: 2025-07-23, DK: 2025-07-21, DE: 2025-07-24

Condition(s): HER2-Expressing (IHC 3+/IHC 2+), Mismatch Repair Proficient (pMMR), Primary Advanced or Recurrent Endometrial Cancer
Product: Rilvegostomig, DS-8201a, MYCOPHENOLATE MOFETIL, PEMBROLIZUMAB, INFLIXIMAB, CARBOPLATIN, DOCETAXEL, PACLITAXEL

Primary endpoint: Progression free survival (PFS) as assessed by BICR defined as time from randomization until progression per RECIST 1.1 as assessed by BICR, or death due to any cause.
Endpoint(s): Overall survival (OS) defined as the time from randomization until the date of death due to any cause., PFS as assessed by investigator (has the same attributes as estimand of PFS by BICR, except tumor assessment is by the investigator)., PFS2 defined as the time from randomization to the earliest of the progression event (following the initial investigator-assessed progression), after first subsequent therapy, or death., ORR as assessed by BICR is defined as the proportion of participants who have a complete response (CR) or partial response (PR), as determined and confirmed by BICR per RECIST 1.1. ORR as assessed and confirmed by the investigator has the same attributes as estimand of ORR by BICR except tumor assessment per the investigator., DoR as assessed by BICR will be defined as the time from the date of first documented response of confirmed responders until date of documented progression per RECIST 1.1 as assessed by BICR or death due to any cause. DoR as assessed by the investigator has the same attributes as estimand of DoR by BICR except tumor assessment per the investigator., Safety and tolerability (evaluated in terms of AEs/serious AEs (SAEs), AESI, vital signs, clinical safety laboratory assessments, ECG and ECHO/MUGA scan results)., Serum concentration of T-DXd, total anti-HER2 antibody, DXd and rilvegostomig., Presence of ADAs for T-DXd and rilvegostomig., Patient-reported tolerability., Assessment of MMR and HER2 expression in tissue samples and their impact to clinical endpoints, addressing clinical utility of the tests.

Source: https://euclinicaltrials.eu/ctis-public/view/2023-508056-19-00